EU clinical trial 2023-506017-22-00: A Phase 2 Study to Evaluate Patient Reported Preference for Subcutaneous Pembrolizumab Coformulated with Hyaluronidase (MK-3475A) Over Intravenous Pembrolizumab Formulation in Participants With Multiple Tumor Types (MK-3475A-F11)
Protocol code: MK-3475A-F11
Sponsor: Merck Sharp & Dohme LLC (Pharmaceutical company). Phase: Therapeutic exploratory (Phase II). Countries: Poland (ongoing, recruitment ended), France (ended).
Therapeutic area(s): Diseases [C] - Neoplasms [C04]
Gender: Female, Male. Age: 18-64 years, 65+ years. Enrolment: 44.
Start date (EU): 2024-02-16. Decision date: 2024-01-26. Results received: No. Last updated: 2026-03-16.
Decision dates by country: FR: 2024-01-26, PL: 2024-01-29

Condition(s): Melanoma, Renal Cell Carcinoma, Non-small cell lung cancer
Product: KEYTRUDA 25 mg/mL concentrate for solution for infusion, MK-3475A

Primary endpoint: Percentage of Participants Who Prefer MK-3475A Subcutaneous (SC) on Patient Preference Questionnaire (PPQ) Question 1
Endpoint(s): Percentage of Responses From Participants to the Two Main Reasons for Their Preferred Method of Administration as Assessed on PPQ Question 3, Percentage of Participants by Their Level of Satisfaction With the SC Method of Administration as assessed on Therapy Administration Satisfaction Questionnaire - Subcutaneous (TASQ-SC) Question 1, Percentage of Participants by Their Level of Satisfaction With the IV Method of Administration as assessed on Therapy Administration Satisfaction Questionnaire -Intravenous (TASQ-IV) Question 1, Percentage of Participants Who Choose MK-3475A SC for the Study Treatment Continuation Period, Number of Participants Who Experience an Adverse Event (AE), Number of Participants Who Discontinue Study Treatment Due to an AE

Source: https://euclinicaltrials.eu/ctis-public/view/2023-506017-22-00